EU clinical trial 2022-502440-12-00: Study evaluating PSMA targeted radionuclide therapy in adult patients with metastatic clear cell renal cancer
Protocol code: PRADR/ET22-313
Sponsor: Centre Leon Berard (Hospital/Clinic/Other health care facility). Phase: Phase I and Phase II (Integrated)- Other. Countries: France (ended).
Therapeutic area(s): Diseases [C] - Female Urogenital Diseases and Pregnancy Complications [C13]; Diseases [C] - Male Urogenital Diseases [C12]; Diseases [C] - Neoplasms [C04]
Gender: Female, Male. Age: 18-64 years, 65+ years. Enrolment: 48.
Status: Ended. Start date (EU): 2023-11-16. End date (EU): 2025-07-16. Decision date: 2023-08-11. Results received: No. Last updated: 2024-06-17.

Condition(s): metastatic clear cell renal cancer with progressive disease after 2 lines of therapy in the advanced/metastatic setting including at least 1 line of anti-VEGFR and 1 line of immunotherapy.

Source: https://euclinicaltrials.eu/ctis-public/view/2022-502440-12-00